EU clinical trial 2024-519514-31-00: A Phase II Trial of atezolizumab plus carboplatin plus nab-paclitaxel as first-line therapy in metastatic Triple-negative PD-L1 positive breast cancer patients
Protocol code: GIM25-CAPT
Sponsor: Consorzio Oncotech (Pharmaceutical company). Phase: Therapeutic exploratory (Phase II). Countries: Italy (ongoing, recruiting).
Therapeutic area(s): Diseases [C] - Neoplasms [C04]
Gender: Female, Male. Age: 18-64 years, 65+ years. Enrolment: 104.
Status: Ongoing, recruiting. Start date (EU): 2025-01-31. Decision date: 2025-01-31. Results received: No. Last updated: 2026-07-03.

Condition(s): metastatic triple-negative PD-L1 positive breast cancer
Product: CARBOPLATIN, ATEZOLIZUMAB, PACLITAXEL ALBUMIN-BOUND

Primary endpoint: % Overall Survival at 2 years
Endpoint(s): % Overall survival at 2.5 years, Overall Survival at 2 years in HR <1% and in HR 1-10%, Post-progression survival, Objective response rate, Time to treatment failure, Incidence and severity of adverse events and seious adverse events

Source: https://euclinicaltrials.eu/ctis-public/view/2024-519514-31-00